EU clinical trial 2022-502500-75-00: DAN-WAR-D - Danish Warfarin-Dialysis Study: Safety and efficacy of warfarin in patients with atrial fibrillation on dialysis -A nationwide parallel-group open randomized clinical trial
Protocol code: 02022018
Sponsor: Rigshospitalet (Hospital/Clinic/Other health care facility). Phase: Therapeutic use (Phase IV). Countries: Denmark (ongoing, recruiting).
Therapeutic area(s): Diseases [C] - Cardiovascular Diseases [C14]
Gender: Female, Male. Age: 18-64 years, 65+ years. Enrolment: 718.
Status: Ongoing, recruiting. Start date (EU): 2024-01-30. Decision date: 2023-01-11. Results received: No. Last updated: 2026-03-27.

Condition(s): Atrial fibrillation, End-stage renal disease
Product: Warfarin Teva 2.5 mg Tablets

Primary endpoint: any transient ischemic attack, ischemic or unspecified stroke or death due to a transient ischemic attack, ischemic or unspecified stroke will be compared between patients allocated warfarin and no treatment.
Endpoint(s): major bleeding defined in accordance with the International Society on Thrombosis and Hemostasis definition pertaining to major bleeding in non-surgical patients, i.e. major intracranial, intraspinal, intraocular, retroperitoneal, intraarticular, pericardial, intramuscular with compartment syndrome, or gastrointestinal bleeding.

Source: https://euclinicaltrials.eu/ctis-public/view/2022-502500-75-00